EU clinical trial 2023-503740-14-00: A Phase 2a, double-blind, placebo-controlled, multi-center, randomized study evaluating LSTA1 when added to standard of care (SoC) versus standard of care alone in subjects with advanced solid tumors (BOLSTER)
Protocol code: LSTA1-P02
Sponsor: Lisata Therapeutics Inc. (Pharmaceutical company). Phase: Therapeutic exploratory (Phase II). Countries: Spain (ended).
Therapeutic area(s): Diseases [C] - Neoplasms [C04]
Gender: Female, Male. Age: 18-64 years, 65+ years. Enrolment: 20.
Status: Ended. End date (EU): 2024-03-15. Decision date: 2023-08-14. Results received: Yes. Last updated: 2024-02-29.

Condition(s): Head and neck cancer, Cholangiocarcinoma
Product: GEMCITABINE, DURVALUMAB, LSTA1, CISPLATIN, Placebo, PACLITAXEL

Primary endpoint: Incidence and severity of adverse events
Endpoint(s): overall survival, progression free survival, Objective response rate, Duration of response

Source: https://euclinicaltrials.eu/ctis-public/view/2023-503740-14-00